EU clinical trial 2025-521811-38-01: Etude de phase II évaluant la capacité d'un agoniste des récepteurs 5-HT4, le prucalopride (Resolor©), à accélérer l'efficacité thérapeutique d'un antidépresseur de type ISRS: preuve de concept clinique.
Protocol code: 38RC24.0407
Sponsor: Centre Hospitalier Universitaire Grenoble Alpes (Hospital/Clinic/Other health care facility). Phase: Therapeutic exploratory (Phase II). Countries: France (authorised, recruitment pending).
Therapeutic area(s): Psychiatry and Psychology [F] - Mental Disorders [F03]
Gender: Female, Male. Age: 18-64 years. Enrolment: 70.
Status: Authorised, recruitment pending. Decision date: 2025-09-16. Results received: No. Last updated: 2025-09-16.

Condition(s): Dépression
Product: Placebo de Prucalopride, ESCITALOPRAM ARROW LAB 10 mg comprimé pelliculé sécable, Prucalopride

Primary endpoint: Evolution moyenne du score HDRS-21 entre J0 et J42, qui sera comparée entre le groupe traité par Escitalopram + Prucalopride et le groupe traité par Escitalopram + placebo.
Endpoint(s): Dimension thymique à J3, J7, J14, J28 et J42 : HDRS-21 (Hamilton Depression Rating Scale-21) - MADRS (Montgomery-Åsberg Depression Rating Scale) - CGI-S (Clinical Global Impressions- Severity) - Visual Analogue Scale -Depression (VAS-D) -, Dimension anxieuse à J3, J7, J14, J28 et J42 : Questionnaire d'anxiété générale (anxiété - trait) de Spielberger ou State-Trait Anxiety Inventory (STAI) - PHQ-9 (Patient Health Questionnaire), Recueil des effets indésirables, en particulier fatigue, troubles gastro-intestinaux, céphalée à chaque visite, Test reconnaissance émotionnelle faciale et test de mémoire émotionnelle à J0, J7 et J42, Score MARS à J7 et J42 et recueil de l’observance par comptage des gélules retournées non utilisées et des blisters vides.

Source: https://euclinicaltrials.eu/ctis-public/view/2025-521811-38-01